EU clinical trial 2023-505621-13-00: CHOP PLUS MOSUNETUZUMAB AS FIRST LINE IN PATIENTS WITH RICHTER´S SYNDROME: A PHASE II STUDY OF THE SPANISH GROUP OF CLL (GELLC-9-RICHTER)
Protocol code: GELLC-9-RICHTER
Sponsor: Grupo Espanol De Leucemia Linfocitica Cronica (Patient organisation/association). Phase: Therapeutic exploratory (Phase II). Countries: Spain (ongoing, recruitment ended).
Therapeutic area(s): Diseases [C] - Hemic and Lymphatic Diseases [C15]
Gender: Female, Male. Age: 18-64 years, 65+ years. Enrolment: 34.
Status: Ongoing, recruitment ended. Start date (EU): 2024-05-14. Decision date: 2024-04-26. Results received: No. Last updated: 2024-04-26.

Condition(s): Richter´syndrome
Product: Vincristina Pfizer 1 mg/ml solución inyectable EFG, Doxorrubicina Accord 2 mg/ml Concentrado para solução para perfusão, Genoxal 200 mg polvo para solución inyectable y para perfusión, Lunsumio 30 mg concentrate for solution for infusion, prednisona cinfa 2,5 mg comprimidos EFG

Primary endpoint: Primary end point will be CR evaluated by an independent review committee according to modified Lugano classification using PET/CT scan (Cheson et al. 2014) at 8-12 weeks after the EoI visit. CR will be defined as a score of 1, 2 or 3 for lymph nodes and extra-lymphatic sites at PET without new lesions and no evidence of fluorodeoxyglucose (FDG)-avid disease in bone marrow. All PET evaluable patients with at least one dose of Mosunetuzumab will be included in the efficacy population.
Endpoint(s): Objective response rate (ORR),Complete remission rate (CR), Best overall response, Minimal residual disease (MRD), Progression free survival (PFS),Overall survival (OS), Duration of response (DOR),, Incidence and severity of adverse events, including for CRS, severity determined according to ASTCT CRS consensus grading criteria (Lee et al 2019); for TLS, presence of laboratory and/or clinical TLS determined according to Howard criteria (Howard et al 2011)., Study treatment exposure (such as treatment duration, total dose received, and number of cycles and dose modifications), Relationship between molecular and genetic prognostic factors as well as clonality and efficacy endpoints, Relationship between MRD response and efficacy endpoints such as PFS and OS.

Source: https://euclinicaltrials.eu/ctis-public/view/2023-505621-13-00